EU clinical trial 2022-500643-20-00: TERTIO : Evaluation of the interest to combine a CD4 Th1-inducer cancer vaccine derived from telomerase and atezolizumab plus bevacizumab in unresectable hepatocellular carcinoma: a proof of concept randomized phase II study
Protocol code: 2022/680
Sponsor: CHUR Of Besançon, Centre Hospitalier Regional Universitaire (Hospital/Clinic/Other health care facility). Phase: Therapeutic exploratory (Phase II). Countries: France (ongoing, recruiting).
Therapeutic area(s): Diseases [C] - Digestive System Diseases [C06]
Gender: Female, Male. Age: 18-64 years, 65+ years. Enrolment: 104.
Status: Ongoing, recruiting. Start date (EU): 2022-09-27. Decision date: 2022-08-01. Results received: No. Last updated: 2026-08-03.

Condition(s): Patients with locally advanced, metastatic or unresectable hepatocellular carcinoma
Product: MVASI 25 mg/mL concentrate for solution for infusion, Tecentriq 1,200 mg concentrate for solution for infusion, UCPVax 1mg/2ml

Primary endpoint: The primary endpoint is the objective response rate (ORR) at 6 months, evaluated by RECIST criteria v1.1. ORR is defined as the addition of complete response (CR) and partial response (PR) rates, evaluated by RECIST criteria v1.1
Endpoint(s): Overall survival (OS): defined as the delay from the date of randomization to death from any cause. Alive patient will be censored at last date known to be alive., Progression-free survival (PFS): defined as the delay from the date of randomization to the disease progression or death from any cause whichever occurs first. Alive patient without progression will be censored at last radiological evaluation available showing no progression, Disease control rate (DCR) at 6 months: defined as the addition of complete response (CR), partial response (PR), and stable disease (SD) rates, evaluated by RECIST criteria v1.1 and imRECIST, Health related quality of life: EORTC-QLQ-C30 every 8 weeks, Toxicities graded according to NCI-CTCAE criteria version 5, To show the ability of UCPvax and atezolizumab plus bevacizumab to promote activity of antigen specific T lymphocytes in the peripheral blood. For this purpose, ELISPOT assays will be performed to measure IFN-γ production of telomerase-specific T cell responses before and after treatment, To characterize the ability of TH1-inducing vaccine (UCPvax) to promote an epitope spreading in HCC patients treated with atezolizumab and bevacizumab. Antigen specific CD8 T cells recognizing glypican, NY-ESO1 peptides were assessed in patients exposed or not to TERT-derived TH1-inducing vaccine, Biomarkers correlated with combined immunotherapy efficacy

Source: https://euclinicaltrials.eu/ctis-public/view/2022-500643-20-00